EU clinical trial 2025-520538-49-00: ACUMEN: Phase I Dose Escalation and Cohort Expansion study to affirm the safety of pharmacological doses of a novel formulation of intravenous melatonin in babies with hypoxic-ischaemic encephalopathy (HIE) to augment therapeutic hypothermia (HT) treatment; to reduce the incidence and severity of disability in babies with moderate-severe HIE.
Protocol code: 146647
Sponsor: University College London (Educational Institution). Phase: Human Pharmacology (Phase I)- First administration to humans. Countries: Ireland (authorised, recruitment pending).
Therapeutic area(s): Diseases [C] - Nervous System Diseases [C10]
Gender: Female, Male. Age: 0-17 years. Enrolment: 17.
Status: Authorised, recruitment pending. Decision date: 2025-09-12. Results received: No. Last updated: 2026-03-03.

Condition(s): Moderate-Severe Hypoxic-Ischaemic Encephalopathy (HIE)
Product: Melatonin in Ethanol

Primary endpoint: Safety: Assessment of the safety profile of melatonin across up to four dose levels based on the occurrence of dose-limiting events (DLEs) during the 172-hour safety window (from the first IMP administration to 100 hours after the final dose)., The attainment of plasma melatonin levels within the range of 15-30mg/L measured at T0, T0+2h, T0+24h, T0+26h, T0+48h, T0+96h across dose levels being studied., The attainment of plasma blood alcohol concentration (BAC) levels <0.25g/L measured at T0, T0+2h, T0+24h, T0+26h, T0+48h, T0+96h across dose levels being studied.
Endpoint(s): Pharmacokinetic Model (PK): Estimation of population PK parameters in the target population (clearance, volume of distribution, half-life, Cmax, AUC) of melatonin and ethanol from plasma samples collected at T0, T0+2h, T0+24h, T0+26h, T0+48h, T0+96h , with interim analyses after recruitment of at least 6 babies (dose level 2), updated with cumulating real-time data prior to every DSMB meeting for dose-escalation decision., 2A) Establishing a Neonatal Neuroprotection Trial Network in anticipation of a Phase II RCT: a) Successful harmonisation of 3T MRI scanners and acquisition of magnetic resonance spectroscopy (MRS) at days 4 to 10: i) Evaluation of pattern and severity of injury using T1/T2 MRI and diffusion-weighted imaging (DWI). ii) Assessment of HIE severity through baseline lactate/N-acetylaspartate (NAA) statistics to inform the sample size calculation of the Phase 2 trial., 2B) Establishing a Neonatal Neuroprotection Trial Network in anticipation of a Phase II RCT: b) Successful (in >90% of enrolled babies) integration of amplitude-integrated electroencephalography aEEG/EEG monitoring throughout the cooling and rewarming periods at all centres, using recovery of background activity as a proxy for outcome (a more rapid recovery of background voltage is associated with a favourable outcome)., 2C) Establishing a Neonatal Neuroprotection Trial Network in anticipation of a Phase II RCT: c) Successful (>90% of enrolled babies) integration of cerebral near-infrared spectroscopy (NIRS) as part of the neurocritical care management for infants with HIE throughout the cooling and rewarming periods at all centres using NIRS as standard care., 2D) Successful collection (>90% of enrolled babies) of early surrogate measures of neurodevelopmental outcomes (The Hammersmith Infant Neurological Examination (HINE) at hospital discharge, Hammersmith Neonatal Neurological Examinations (HNNE) at day 90 General Movement Assessment (GMA) at hospital discharge and day 90, and Ages & Stages Questionnaires (ASQ-3) at day 90)., Recruitment: a. Metrics on the acceptability of the study among potential participants’ parent/legal guardian(s) assessed through screening and enrolment logs that capture consent rates and reasons for non-consent b. Rates of informed consent obtained within the 6-hour timeframe. c. Timelines and initiation of the first dose administration within the specified 6-hour window.

Source: https://euclinicaltrials.eu/ctis-public/view/2025-520538-49-00